EU clinical trial 2023-508915-22-00: Fentanyl effect on ventilatory pattern under sham postsurgical conditions – an exploratory study in healthy men and women – the FAME study
Sponsor: Academisch Ziekenhuis Leiden (Hospital/Clinic/Other health care facility). Phase: Therapeutic confirmatory (Phase III). Countries: Netherlands (ended).
Therapeutic area(s): Analytical, Diagnostic and Therapeutic Techniques and Equipment [E] - Anesthesia and Analgesia [E03]
Gender: Female, Male. Age: 18-64 years. Enrolment: 12.
Status: Ended. Start date (EU): 2024-03-04. End date (EU): 2024-04-26. Decision date: 2024-01-15. Results received: Yes. Last updated: 2024-01-15.

Condition(s): none, healthy subjects
Product: Fentanyl hameln 50 microgram/ml, oplossing voor injectie, Naloxone 400 micrograms/ml solution for injection/infusion

Primary endpoint: Arterial PCO2 in the recovery phase of the study (i.e. the last 90 min of the study)
Endpoint(s): Respiratory events are defined by: 1) Respiratory rate ≤5 breaths/min for ≥3 min; 2) Oxygen saturation ≤ 85% for ≥ 3 min; 3) End-tidal PCO2 ≤ 2 kPa or ≥ 8 kPa for ≥ 3 min; 4) or apnea for at least 30 s; 5) any other respiratory event., Arterial versus venous versus end-tidal PCO2 at regular intervals

Source: https://euclinicaltrials.eu/ctis-public/view/2023-508915-22-00